EU clinical trial 2023-507291-52-00: A PHASE II STUDY OF CHLORAMBUCIL IN COMBINATION WITH SUBCUTANEOUS RITUXIMAB FOLLOWED BY MAINTENANCE THERAPY WITH SUBCUTANEOUS RITUXIMAB IN PATIENTS WITH EXTRANODAL MARGINAL ZONE B-CELL LYMPHOMA OF MUCOSA ASSOCIATED LYMPHOID TISSUE (MALT LYMPHOMA)
Protocol code: IELSG38
Sponsor: Association International Extranodal Lymphoma Study Group (IELSG) (Laboratory/Research/Testing facility). Phase: Therapeutic exploratory (Phase II). Countries: France (ended), Italy (ended).
Therapeutic area(s): Diseases [C] - Neoplasms [C04]
Gender: Female, Male. Age: 18-64 years, 65+ years. Enrolment: 106.
Status: Ended. Start date (EU): 2014-03-24. End date (EU): 2026-05-27. Decision date: 2024-10-01. Results received: No. Last updated: 2025-11-25.
Decision dates by country: FR: 2024-10-01, IT: 2024-10-07

Condition(s): Extranodal Marginal Zone Lymphoma
Product: MabThera 500 mg concentrate for solution for infusion, MabThera 1400 mg solution for subcutaneous injection, CHLORAMBUCIL

Primary endpoint: Complete Remission rate at the end of induction phase (6 months)
Endpoint(s): Response Rate (Complete and partial remission rates) at the end of induction phase ( 6 months from study entry), Progression Free Survival, Event-free-survival (EFS) at 5 years, Overall survival, Response duration, Acute and long-term toxicity

Source: https://euclinicaltrials.eu/ctis-public/view/2023-507291-52-00